EU clinical trial 2024-515375-35-00: Primary comparison of Liposomal Anthracycline based treatment versus conventional care strategies prior to allogeneic stem cell transplantation in patients with higher risk MDS or oligoblastic AML
Protocol code: PALOMA
Sponsor: GWT-Tud GmbH (Pharmaceutical company). Phase: Therapeutic exploratory (Phase II). Countries: Austria (ongoing, recruitment ended), Germany (ongoing, recruitment ended).
Therapeutic area(s): Diseases [C] - Hemic and Lymphatic Diseases [C15]
Gender: Female, Male. Age: 18-64 years, 65+ years. Enrolment: 150.
Status: Ongoing, recruitment ended. Start date (EU): 2019-08-26. Decision date: 2024-10-20. Results received: No. Last updated: 2026-03-06.
Decision dates by country: AT: 2024-10-20, DE: 2024-10-24

Condition(s): Untreated patients with higher risk MDS and oligoblastic AML eligible and intended for allogeneic HCT within the next 6 months
Product: AZACITIDINE, DAUNORUBICIN HYDROCHLORIDE, CYTARABINE, AZACITIDINE, DAUNORUBICIN HYDROCHLORIDE, CYTARABINE, Vyxeos Liposomal 44 mg/100 mg powder for concentrate for solution for infusion.

Primary endpoint: EFS with a data cut off date of September 2025
Endpoint(s): Best and overall response rate according to AML-ELN and MDS-IWG criteria, Toxicity as measured by NCI CTCAE v5.0, Proportion of patients proceeding to alloHCT, MRD assessed at all times of BM puncture, Quality of life as measured by EORTC-QLQ30 supplemented by information on self-assessed concomitant diseases and demographics upon inclusion and at EOT (i.e. before alloHCT, if applicable), Key Secondary Endpoint: OS with a data cut-off dates of September 2025 for interim and September 2026 for final

Source: https://euclinicaltrials.eu/ctis-public/view/2024-515375-35-00